EU clinical trial 2023-509630-19-00: A Phase 3, Multicenter, Randomized, Open-label Study of Ifinatamab Deruxtecan (I-DXd) in Subjects with Pretreated Advanced or Metastatic Esophageal Squamous Cell Carcinoma (ESCC) (IDeate-Esophageal01)
Protocol code: DS7300-202
Sponsor: Daiichi Sankyo Inc. (Pharmaceutical company). Phase: Therapeutic confirmatory (Phase III). Countries: Norway (authorised, recruitment pending), Poland (ongoing, recruiting), Denmark (authorised, recruitment pending), Italy (ongoing, recruiting), Romania (ongoing, recruiting), France (ongoing, recruiting), Spain (ongoing, recruiting), Sweden (authorised, recruitment pending), Germany (authorised, recruitment pending), Netherlands (authorised, recruitment pending), Belgium (ongoing, recruiting).
Therapeutic area(s): Diseases [C] - Neoplasms [C04]
Gender: Female, Male. Age: 18-64 years, 65+ years. Enrolment: 198.
Start date (EU): 2025-07-31. Decision date: 2025-06-17. Results received: No. Last updated: 2026-06-24.
Decision dates by country: ES: 2025-06-19, BE: 2025-06-17, DE: 2025-06-23, FR: 2025-06-18, IT: 2025-06-19, NL: 2025-06-17, DK: 2025-06-17, RO: 2025-06-23, PL: 2025-06-24, SE: 2025-06-17, NO: 2025-06-20

Condition(s): Esophageal Squamous Cell Carcinoma (ESCC)
Product: Ifinatamab deruxtecan, IRINOTECAN HYDROCHLORIDE, DOCETAXEL, PACLITAXEL

Primary endpoint: OS is defined as the time interval from the date of randomization to the date of death due to any cause.
Endpoint(s): PFS is defined as the time interval from the date of randomization to the first date of disease progression as determined by BICR per RECIST v1.1 or death due to any cause, whichever occurs first., ORR is defined as the proportion of subjects with a BOR of confirmed CR or confirmed PR as assessed by BICR per RECIST v1.1., DoR is defined as the time from the date of first documentation of objective tumor response (CR or PR), which is subsequently confirmed by BICR assessment, to the first documentation of objective tumor progression (confirmed by BICR) or to death due to any cause, whichever occurs first. TTR is defined as the time from randomization to the date of the first documentation of objective response by BICR assessment in responders (BOR of confirmed CR or confirmed PR)., DCR is defined as the proportion of subjects with a BOR of confirmed CR, confirmed PR, or SD according to RECIST v1.1 and will be determined by BICR assessment review of tumor scans., The following subscales from validated instruments will be used to assess PROs: EORTC QLQ-C30 – Global Health Status/Quality of Life scale, physical functioning, and fatigue EORTC OES18 – Dysphagia, trouble with eating, reflux, and pain. Change in scores from baseline throughout the Treatment Period will be measured for each scale., Incidence of TEAEs, serious TEAEs, and AESIs graded according to the NCI‑CTCAE v5.0, including deaths, changes from baseline in vital signs, clinical laboratory results, ECGs, and ECHO/MUGA., ADA measured in plasma with a validated assay. ADA prevalence: The proportion of subjects who are ADA positive at any point in time (including pre existing ADA at baseline and treatment emergent ADA). ADA incidence: The proportion of subjects having treatment emergent ADA. Titer and neutralizing antibodies will be determined when the ADA is positive., B7-H3 protein expression in tumor tissue at baseline as determined by IHC and correlation with OS and other efficacy endpoints, Plasma concentrations at each time point and PK parameters (Cmax, Tmax, AUClast, and AUCtau) for I DXd, total anti B7-H3 antibody, and DXd in the full PK subset.

Source: https://euclinicaltrials.eu/ctis-public/view/2023-509630-19-00